EU clinical trial 2023-503240-13-00: A Phase 3, Randomized, Double-Blind, Placebo-Controlled, Parallel-Arm Study to Evaluate the Efficacy and Safety of RZ358 in Patients with Congenital Hyperinsulinism
Protocol code: RZ358-301
Sponsor: Rezolute Inc. (Industry). Phase: Therapeutic confirmatory (Phase III). Countries: Denmark (ongoing, recruitment ended), Spain (ongoing, recruitment ended), Greece (ongoing, recruitment ended), Bulgaria (ongoing, recruitment ended), France (ongoing, recruitment ended), Germany (ongoing, recruitment ended).
Therapeutic area(s): Diseases [C] - Nutritional and Metabolic Diseases [C18]
Gender: Female, Male. Age: 0-17 years, 18-64 years. Enrolment: 32.
Status: Ongoing, recruitment ended. Start date (EU): 2024-01-30. Decision date: 2023-12-18. Results received: No. Last updated: 2026-04-20.
Decision dates by country: ES: 2023-12-18, BG: 2024-01-08, FR: 2024-01-03, DE: 2023-12-21, DK: 2023-12-19, GR: 2023-12-22

Condition(s): Hypoglycemia associated with congenital hyperinsulinism
Product: RZ358 placebo is a sterile solution for parenteral administration with a minimum extractable volume of 1.0 mL in an ISO 2R, type I clear glass vial with a fluoropolymer-faced, grey chlorobutyl rubber stopper, and an aluminum seal with plastic flip-off cap. The buffered vehicle nominal composition is as follows: 10mM L-histidine, 10mM L- methionine, 270mM sorbitol, 0.01% polysorbate 20, pH 5.8.

Primary endpoint: Change in average weekly incidence of hypoglycemia events (<70 mg/dL or <3.9 mmol/L) by SMBG after 24 weeks.
Endpoint(s): Change in average daily percent time in hypoglycemia (<70 mg/dL or <3.9 mmol/L) by CGM after 24 weeks., Safety and tolerability of RZ358 based on assessments of AEs, SAEs, clinical laboratory measurements, ECG, vital signs, physical examination, immunogenicity assessments, hepatic ultrasound, and incidence of hyperglycemia events by SMBG at thresholds of >250 mg/dL and >300 mg/dL (>13.9 mmol/L and >16.7 mmol/L, respectively.), a. -Change in average weekly incidence of potentially serious hypoglycemia events by SMBG -Change in average daily percent time with potentially serious hypoglycemia by CGM -Change in average 8-hour overnight percent time with hypoglycemia by CGM, b. -Change in average daily duration (min) with hypoglycemia by CGM -Proportion of participants achieving <4% average daily time in hypoglycemia by CGM -Proportion of participants experiencing no potentially serious hypoglycemia events by SMBG, The repeat-dose PK profile of RZ358 assessed by popPK modeling, which will be used to estimate PK parameters by dose and age category.

Source: https://euclinicaltrials.eu/ctis-public/view/2023-503240-13-00